EU clinical trial 2024-514878-53-00: AVENHIR trial: Phase II study with safety run-in of Azacitidine (AZA) combined with Venetoclax (VEN) in patients with higher-risk Chronic Myelomonocytic Leukemia (CMML)
Protocol code: AVENHIR
Sponsor: Groupe Francophone Des Myelodysplasies (Patient organisation/association). Phase: Therapeutic exploratory (Phase II). Countries: France (ongoing, recruitment ended).
Therapeutic area(s): Diseases [C] - Hemic and Lymphatic Diseases [C15]
Gender: Female, Male. Age: 18-64 years, 65+ years. Enrolment: 44.
Status: Ongoing, recruitment ended. Start date (EU): 2023-10-04. Decision date: 2024-09-25. Results received: No. Last updated: 2025-04-01.

Condition(s): HMA-naïve, higher-risk (HR, defined as CPSS-mol risk intermediate-2 or high) CMML patients
Product: Vidaza 25 mg/ml powder for suspension for injection, Venetoclax, Venetoclax, Venetoclax

Primary endpoint: Safety run-in: dose-limiting toxicity occurring within the first two cycles of treatment, Phase II: Overall response rate (ORR) after 3 and 6 cycles according to protocol-defined criteria modified from MDS/MPN IWG criteria (Savona Blood. 2015 Mar 19; 125(12): 1857–1865). Overall response includes complete remission (CR), partial remission (PR), marrow response (MR) and clinical benefit (CB).
Endpoint(s): CR rate after 3 and 6 cycles according to modified MDS/MPN IWG criteria, ORR at best response according to modified MDS/MPN IWG criteria, ORR after 3 and 6 cycles, and at best response according to DACOTA response criteria (ie modified MDS IWG 2006 criteria, Braun Blood 2011), Duration of Response (according to modified MDS/MPN IWG criteria), Safety profile (both hematological and non-hematological) of venetoclax in combination with azacitidine, Overall Survival (OS), AML-free survival (AMLFS), Progression-free survival (PFS), Event-free survival (EFS), Cumulative incidence of AML and cumulative risk of death without AML, Cumulative incidence of progressive disease (or AML transformation) and cumulative risk of death without progression or AML transformation, Rate of HSCT and post-HSCT OS and AMLFS, OS, AMLFS and PFS censoring at HSCT, Rate and description of subsequent therapy, OS, AMLFS and PFS censoring at subsequent therapy

Source: https://euclinicaltrials.eu/ctis-public/view/2024-514878-53-00